EU clinical trial 2024-516547-11-00: Uptake and biodistribution of 89Zirconium-labeled ipilimumab in ipilimumab treated patients with metastatic melanoma
Sponsor: Stichting Amsterdam UMC (Hospital/Clinic/Other health care facility). Phase: Therapeutic exploratory (Phase II). Countries: Netherlands (ongoing, recruitment ended).
Therapeutic area(s): Diseases [C] - Neoplasms [C04]
Gender: Female, Male. Age: 18-64 years. Enrolment: 24.
Status: Ongoing, recruitment ended. Start date (EU): 2024-10-08. Decision date: 2024-10-08. Results received: No. Last updated: 2024-10-08.

Condition(s): skincancer, advanced melanoma
Product: YERVOY 5 mg/ml concentrate for solution for infusion

Primary endpoint: The detection of 89Zr-ipilimumab in tumor lesions. Tumor lesions will be defined using a diagnostic CT-scan or MRI. The short axis diameter of a measurable tumor lesion is ≥1 cm. The five largest lesions will be used for evaluation.
Endpoint(s): Response after starting therapy with ipilimumab/nivolumab combination therapy at 12 and 24 weeks and every 12 weeks thereafter, Overall survival, The detection (visual and quantitative) of 89Zr-ipilimumab in normal tissue, Adverse events using Common Terminology Criteria Adverse Events, version 4.0 (CTCAE 4.0) & Correlation between side effects of ipilimumab/nivolumab combination therapy and uptake of 89Zr-ipilimumab in normal tissue, CTLA-4+CD4+ expression of PBMCs (before start of ipilimumab and during treatment), Correlation between CTLA-4+CD4+ expression of PBMCs and uptake of 89Zripilimumab in tissues., Pharmacokinetics & dosimetry of 89Zr-ipilimumab, The SUV in tumor lesions will be compared to the SUV in blood. Specific uptake of ipilimumab in tumor lesions is defined as SUVtumor/SUVblood>1., CTLA-4 expression on tumor infiltrating lymphocytes

Source: https://euclinicaltrials.eu/ctis-public/view/2024-516547-11-00